EU clinical trial 2025-522313-38-00: J2S-MC-GZME: A Phase 3, Multicenter, Randomized, Double-Blind Study to Investigate the Efficacy and Safety of Brenipatide Compared with Placebo for the Treatment of Adult Participants with Moderate-to-Severe Alcohol Use Disorder (RENEW-ALC-1)
Protocol code: J2S-MC-GZME
Sponsor: Eli Lilly & Co. (Pharmaceutical company). Phase: Therapeutic confirmatory (Phase III). Countries: Belgium (ongoing, recruitment ended), Germany (ongoing, recruitment ended).
Therapeutic area(s): Psychiatry and Psychology [F] - Behavioral Disciplines and Activities [F04]
Gender: Female, Male. Age: 18-64 years. Enrolment: 97.
Status: Ongoing, recruitment ended. Start date (EU): 2026-03-06. Decision date: 2026-02-05. Results received: No. Last updated: 2026-07-20.
Decision dates by country: DE: 2026-02-09, BE: 2026-02-05

Condition(s): Alcohol Use Disorder
Product: Brenipatide, Brenipatide, Brenipatide, Placebo to match LY

Primary endpoint: Behaviors Associated with Alcohol Use Disorder (AUD) as Assessed by the Timeline Followback Method (TLFB)

Source: https://euclinicaltrials.eu/ctis-public/view/2025-522313-38-00